EU clinical trial 2024-511967-26-00: A Randomized Phase 3 Study to Evaluate the Efficacy and Safety of Daratumumab in Combination with Cyclophosphamide, Bortezomib and Dexamethasone (CyBorD) Compared With CyBorD Alone in Newly Diagnosed Systemic AL Amyloidosis
Protocol code: 54767414AMY3001
Sponsor: Janssen Cilag International (Pharmaceutical company). Phase: Therapeutic confirmatory (Phase III). Countries: Denmark (ended), Italy (ended), Netherlands (ended), Belgium (ended), Hungary (ended), Germany (ended), Greece (ended), Sweden (ended), Spain (ended), France (ended), Poland (ended).
Therapeutic area(s): Diseases [C] - Neoplasms [C04]
Gender: Female, Male. Age: 18-64 years, 65+ years. Enrolment: 108.
Status: Ended. Start date (EU): 2016-11-21. End date (EU): 2024-11-13. End date: 2024-11-19. Decision date: 2024-06-20. Results received: Yes. Last updated: 2024-07-22.
Decision dates by country: BE: 2024-06-21, DK: 2024-06-20, FR: 2024-06-25, DE: 2024-06-20, GR: 2024-07-22, HU: 2024-06-25, IT: 2024-07-08, ES: 2024-06-21, SE: 2024-06-20, NL: 2024-06-21, PL: 2024-07-15

Condition(s): AL Amyloidosis (Newly Diagnosed Systemic AL Amyloidosis)
Product: VELCADE 3.5 mg powder for solution for injection, Cyclophosphamide Tablets 50 mg, JNJ-54767414, Dexamethason 4 mg JENAPHARM®

Primary endpoint: The primary endpoint is overall complete hematologic response (CHR) rate.

Source: https://euclinicaltrials.eu/ctis-public/view/2024-511967-26-00